EU clinical trial 2023-509532-25-00: First-in human, dose escalation and cohort expansion study for the evaluation of LB-208 (HTR1B antagonist) in adult patients with relapsed or refractory solid tumours and lymphoma
Protocol code: LB-208-001
Sponsor: Leukos Biotech S.L. (Pharmaceutical company). Phase: Human Pharmacology (Phase I)- First administration to humans. Countries: Spain (ongoing, recruiting).
Therapeutic area(s): Diseases [C] - Neoplasms [C04]
Gender: Female, Male. Age: 18-64 years, 65+ years. Enrolment: 57.
Status: Ongoing, recruiting. Start date (EU): 2024-08-07. Decision date: 2024-06-11. Results received: No. Last updated: 2026-02-02.

Condition(s): Solid tumor, Lymphoma

Source: https://euclinicaltrials.eu/ctis-public/view/2023-509532-25-00